EU clinical trial 2024-515442-17-00: Evaluation of safety, side effects and how the inhaled drug CHF10073 is absorbed, modified and removed from the body when administered alone or in combination with itraconazole in male and female healthy adults
Protocol code: CLI-010073AA1-01
Sponsor: Chiesi Farmaceutici S.p.A. (Pharmaceutical company). Phase: Human Pharmacology (Phase I)- First administration to humans. Countries: Belgium (ended).
Therapeutic area(s): Diseases [C] - Respiratory Tract Diseases [C08]
Gender: Female, Male. Age: 18-64 years. Enrolment: 156.
Status: Ended. Start date (EU): 2024-12-03. End date (EU): 2026-02-04. Decision date: 2024-11-06. Results received: No. Last updated: 2025-08-29.

Condition(s): Pulmonary fibrosis

Source: https://euclinicaltrials.eu/ctis-public/view/2024-515442-17-00